EU clinical trial 2024-513731-24-00: A randomized phase II study of neo-adjuvant chemo/immunotherapy versus chemo-therapy alone for the treatment of locally advanced and potentially resectable non-small cell lung cancer (NSCLC) patients_NADIM II
Sponsor: Fundacion GECP (Patient organisation/association). Phase: Therapeutic exploratory (Phase II). Countries: Spain (ended).
Therapeutic area(s): Diseases [C] - Neoplasms [C04]
Gender: Female, Male. Age: 18-64 years, 65+ years. Enrolment: 90.
Status: Ended. Start date (EU): 2019-05-14. End date (EU): 2026-04-02. Decision date: 2024-06-10. Results received: No. Last updated: 2025-07-22.

Condition(s): Non-small cell lung cancer (NSCLC)
Product: OPDIVO 10 mg/mL concentrate for solution for infusion.

Primary endpoint: Pathological Complete Response (pCR)
Endpoint(s): 1. Overall survival, 2.Progression-free survival, 3. Major pathological response rate, 4. Downstaging, 5. Portion of delayed/canceled surgeries, length of hospital stays, surgical approach, incidence of AE/SAE related to surgery, 6. Mortality at 90 days after surgery, 7. Safety and tolerability: Adverse events graded according to CTCAE v5.0, 8. Biomarker endpoints, 9. To determine the association between MPR and histology, 10. To determine the association of the histology with the progression free survival at 18 months

Source: https://euclinicaltrials.eu/ctis-public/view/2024-513731-24-00